EU clinical trial 2024-510695-20-00: A Phase IIIb Randomised, Parallel-Group, Double-Blind, Placebo-Controlled, Two-Arm Study to Evaluate the Effect of Elafibranor 80 mg on Normalisation of Alkaline Phosphatase in Adult Participants with Primary Biliary Cholangitis (PBC) and Inadequate Response or Intolerance to Ursodeoxycholic Acid
Protocol code: CLIN-60190-463
Sponsor: Ipsen Bioscience Inc. (Pharmaceutical company). Phase: Therapeutic confirmatory (Phase III). Countries: Germany (ended), Poland (ended), Czechia (ended), France (ended), Spain (ended), Italy (ended), Romania (ended).
Therapeutic area(s): Diseases [C] - Digestive System Diseases [C06]
Gender: Female, Male. Age: 18-64 years, 65+ years. Enrolment: 35.
Status: Ended. Start date (EU): 2024-10-15. End date (EU): 2026-06-04. End date: 2026-06-16. Decision date: 2024-09-30. Results received: No. Last updated: 2026-07-17.
Decision dates by country: CZ: 2024-10-01, FR: 2024-09-30, IT: 2024-09-30, ES: 2024-09-30, RO: 2025-01-21, DE: 2024-09-30, PL: 2024-09-30

Condition(s): Primary Biliary Cholangitis (PBC)
Product: Elafibranor Placebo, elafibranor

Primary endpoint: Percentage of participants with normalisation of ALP at Week 52
Endpoint(s): Percentage of participants with normalisation of ALP Levels [Time Frame: From baseline to Week 4, Week 12, Week 24 and Week 36], Change from baseline in ALP levels [Time Frame: From baseline to Week 4, Week 12, Week 24, Week 36 and Week 52], Percentage of participants with normalisation of ALP Levels and ≥15% decrease from Baseline [Time Frame: From baseline to Week 4, Week 12, Week 24, Week 36 and Week 52], Percentage of participants with ≥40% decrease from Baseline in ALP Levels [Time Frame: From baseline to Week 4, Week 12, Week 24, Week 36 and Week 52], Percentage of participants with ALP <0.5 × Upper Limit of Normal (ULN) [Time Frame: At Week 4, Week 12, Week 24, Week 36 and Week 52], Changes from baseline in Total Bilirubin (TB) Levels [Time Frame: From baseline to Week 4, Week 12, Week 24, Week 36 and Week 52], Percentage of participants with TB <0.7 × ULN [Time Frame: At Week 4, Week 12, Week 24, Week 36 and Week 52], Percentage of participants with normalisation of ALP and TB <0.7 × ULN [Time Frame: At Week 4, Week 12, Week 24, Week 36 and Week 52], Percentage of participants with normalisation of TB and ALP Levels [Time Frame: At Week 4, Week 12, Week 24, Week 36 and Week 52], Percentage of participants with complete biochemical response [Time Frame: At Week 4, Week 12, Week 24, Week 36 and Week 52], Change from baseline in PBC Worst Itch Numeric Rating Scale (NRS) score [Time Frame: From baseline through Week 52], Percentage of participants with moderate to severe pruritus at baseline (i.e. score ≥4) with a clinically meaningful response in PBC Worst Itch NRS [Time Frame: From baseline through Week 52], Change from baseline in 5-D itch score [Time Frame: From baseline to Week 4, Week 24, and Week 52], Change from baseline in Patient Global Impression of Severity (PGI-S) scores [Time Frame: From baseline to Week 4, Week 24, and Week 52], Patient Global Impression of Change (PGI-C) scores [Time Frame: At Week 4, Week 24, and Week 52], Change from baseline in PBC-40 Quality of Life (QoL) scores [Time Frame: From baseline to Week 4, Week 24, and Week 52], Change from baseline in Patient-Reported Outcomes Measurement Information System (PROMIS) Fatigue Short Form 7a scores [Time Frame: From baseline to Week 4, Week 24, and Week 52], Percentage of participants experiencing Treatment- Emergent Adverse Events (TEAEs), treatment- related TEAEs, Serious Adverse Events (SAEs) and Adverse Events of Special Interest (AESIs). [Time Frame: From baseline until 4 weeks after the end of treatment (maximum duration of 52 weeks)], Percentage of participants developing clinically significant changes in physical examination [Time Frame: From baseline until 4 weeks after the end of treatment (maximum duration of 52 weeks)], Percentage of participants developing clinically significant changes in vital signs [Time Frame: From baseline until 4 weeks after the end of treatment (maximum duration of 52 weeks)], Percentage of participants developing clinically significant changes in Electrocardiogram (ECG) Readings [Time Frame: From baseline until 4 weeks after the end of treatment (maximum duration of 52 weeks)], Percentage of participants developing clinically significant changes in laboratory parameters [Time Frame: From baseline until 4 weeks after the end of treatment (maximum duration of 52 weeks)]

Source: https://euclinicaltrials.eu/ctis-public/view/2024-510695-20-00